EU clinical trial 2022-501106-35-00: I8F-MC-GPHJ: A Phase 3b, Randomized Controlled Study to Evaluate the Efficacy and Safety of Tirzepatide Compared to Semaglutide 2.4 mg in Adults Who Have Obesity or Overweight with Weight-Related Comorbidities
Protocol code: 17203
Sponsor: Eli Lilly & Co. (Pharmaceutical company). Phase: Therapeutic confirmatory (Phase III). Countries: Germany (ended), Belgium (ended), Poland (ended).
Therapeutic area(s): Diseases [C] - Nutritional and Metabolic Diseases [C18]
Gender: Female, Male. Age: 18-64 years, 65+ years. Enrolment: 143.
Status: Ended. End date (EU): 2023-10-10. Decision date: 2023-01-26. Results received: No. Last updated: 2023-02-03.
Decision dates by country: BE: 2023-01-26, DE: 2023-01-30, PL: 2023-02-03

Condition(s): Obesity; Overweight
Product: Tirzepatide, SEMAGLUTIDE, Tirzepatide, SEMAGLUTIDE, SEMAGLUTIDE, Tirzepatide, Tirzepatide, Tirzepatide, SEMAGLUTIDE, SEMAGLUTIDE, Tirzepatide

Primary endpoint: Percent Change from Baseline in Body Weight
Endpoint(s): Percentage of Participants Who Achieve ≥10% Body Weight Reduction, Percentage of Participants Who Achieve ≥15% Body Weight Reduction, Percentage of Participants Who Achieve ≥20% Body Weight Reduction, Percentage of Participants Who Achieve ≥25% Body Weight Reduction, Change from Baseline in Waist Circumference Centimeter (cm), Change from Baseline in Who Achieve ≥30% Body Weight Reduction, Change from Baseline in Body Mass Index (BMI)

Source: https://euclinicaltrials.eu/ctis-public/view/2022-501106-35-00